EU clinical trial 2023-503415-15-00: A clinical trial to learn how an investigational drug (vimseltinib) is absorbed, distributed, broken down, and removed from the body when given to people with liver problems
Protocol code: DCC-3014-01-004
Sponsor: Deciphera Pharmaceuticals Inc. (Pharmaceutical company). Phase: Human Pharmacology (Phase I)- Other. Countries: Hungary (ended).
Therapeutic area(s): Diseases [C] - Neoplasms [C04]
Gender: Female, Male. Age: 18-64 years, 65+ years. Enrolment: 32.
Status: Ended. Start date (EU): 2023-12-21. End date (EU): 2025-12-05. End date: 2025-12-06. Decision date: 2023-09-15. Results received: No. Last updated: 2023-12-20.

Condition(s): Tenosynovial Giant Cell Tumor (TGCT), Malignant Solid Tumors (MST)

Source: https://euclinicaltrials.eu/ctis-public/view/2023-503415-15-00